EU clinical trial 2023-508196-36-00: Primary treatment of follicular lymphoma with rituximab-lenalidomide-tafasitamab for high-risk disease and rituximab-lenalidomide with a 1:1 randomization to tafasitamab for low-risk disease: a phase II study – NLG-FL7
Sponsor: Karolinska University Hospital (Hospital/Clinic/Other health care facility). Phase: Therapeutic exploratory (Phase II). Countries: Finland (ongoing, recruiting), Denmark (ongoing, recruiting), Iceland (ongoing, recruiting), Norway (ongoing, recruiting), Sweden (ongoing, recruiting).
Therapeutic area(s): Diseases [C] - Neoplasms [C04]
Gender: Female, Male. Age: 18-64 years, 65+ years. Enrolment: 270.
Status: Ongoing, recruiting. Start date (EU): 2025-05-27. Decision date: 2025-02-26. Results received: No. Last updated: 2026-06-16.
Decision dates by country: SE: 2025-02-27, DK: 2025-02-27, NO: 2025-02-26, IS: 2025-03-05, FI: 2025-02-27

Condition(s): Follicular lymphoma
Product: RITUXIMAB, MINJUVI 200 mg powder for concentrate for solution for infusion, LENALIDOMIDE

Primary endpoint: EFS24, defined as the interval between treatment start and progression or new lymphoma treatment or death, whichever occurs first, within 2 years of study entry.
Endpoint(s): EFS, defined as the interval between treatment start and progression or new lymphoma treatment or death, whichever occurs first., PFS, defined as the interval between treatment start and progression or death, whichever occurs first., POD24, defined as the interval between treatment start and progression or death, whichever occurs first, within 2 years of study entry., OS, defined as the interval between treatment start and death., ORR, defined as the sum of the rates of CR or PR at best response., CRR, defined as the sum of the rates of CR at best response., LSS, defined as the interval between treatment start and death of lymphoma (other causes are censored at the date of death)., Time to next treatment, defined as the interval between treatment start and that of documented new anti-lymphoma therapy., Duration of response, defined as the interval between when criteria for response (CR or PR) are met to the first documentation of progression., Incidence of transformation. Cases of transformation are documented with respect to transformation type and date., Safety based on the incidence and severity of AEs. Frequency and duration of all grade 3-5 treatment-related adverse events (AEs) according to CTCAE 5.0., HR-QoL as measured by EORTC QLQ-C30

Source: https://euclinicaltrials.eu/ctis-public/view/2023-508196-36-00